EU clinical trial 2023-506384-34-00: A Phase 1/2 Open-Label Rolling-Arm Umbrella Platform Study of Investigational Agents With or Without Pembrolizumab in Participants with PD-1/L1 Refractory Locally Advanced or Metastatic Urothelial Carcinoma (KEYMAKER-U04): Substudy 04A
Protocol code: MK-3475-04A
Sponsor: Merck Sharp & Dohme LLC (Pharmaceutical company). Phase: Phase I and Phase II (Integrated)- First administration to humans. Countries: Spain (ongoing, recruiting), Netherlands (ongoing, recruiting), Italy (ongoing, recruiting), Denmark (ongoing, recruiting).
Therapeutic area(s): Diseases [C] - Neoplasms [C04]
Gender: Female, Male. Age: 18-64 years, 65+ years. Enrolment: 15.
Status: Ongoing, recruiting. Start date (EU): 2025-11-05. Decision date: 2024-06-19. Results received: No. Last updated: 2026-02-20.
Decision dates by country: NL: 2024-06-19, ES: 2024-07-26, IT: 2024-07-15, DK: 2024-07-04

Condition(s): Locally advanced or metastatic urothelial carcinoma
Product: PEMBROLIZUMAB, MK-3120, Zilovertamab vedotin

Primary endpoint: Percentage of Participants Who Experienced At Least One Adverse Event (AE), Percentage of Participants Who Discontinued Study Treatment Due to an AE, Arm A: Objective Response Rate (ORR) as Assessed by Blinded Independent Central Review (BICR), Arm B: ORR as Assessed by Investigator
Endpoint(s): Arm A: Duration of Response (DOR) as Assessed by BICR, Arm B: DOR as Assessed by Investigator

Source: https://euclinicaltrials.eu/ctis-public/view/2023-506384-34-00